EU clinical trial 2024-517763-22-00: Midazolam and mORPHine to alleviate symptoms at the End of life in patients on acUte geriatric wardS (MORPHEUS study)
Sponsor: UZ Leuven (Hospital/Clinic/Other health care facility). Phase: Therapeutic use (Phase IV). Countries: Belgium (ended).
Therapeutic area(s): Diseases [C] - Pathological Conditions, Signs and Symptoms [C23]
Gender: Female, Male. Age: 65+ years. Enrolment: 300.
Status: Ended. Start date (EU): 2025-02-03. End date (EU): 2025-12-31. Decision date: 2025-01-20. Results received: No. Last updated: 2026-01-29.

Condition(s): Symptom treatment in the last days of life of geriatric patients
Product: MORPHINE, MIDAZOLAM

Primary endpoint: Morphine and midazolam doses, time of administration and route of administration, Symptom control: discomfort scale, agitation/sedation scale and dyspnea scale, Adverse reactions: : nausea, vomiting, hallucinations, constipation, myoclonus, pruritus, hiccups, respiratory rate and other adverse reactions occurring that are related to the Morphine and Midazolam injection according to the nurse or doctor.
Endpoint(s): Morphine, morphine-3-glucuronide and morphine-6-glucuronide plasma concentrations, Midazolam and alpha-hydroxy-midazolam glucuronide plasma concentrations, Blood creatinine, urea, albumin, bilirubin, GGT, ALT, sodium, CRP and urinary creatinine concentrations

Source: https://euclinicaltrials.eu/ctis-public/view/2024-517763-22-00